EU clinical trial 2023-506856-25-00: Phase IIb, randomised, controlled, unblinded, multicentre, clinical trial to evaluate the clinical efficacy of a nanostructured fibrin-agarose artificial cornea model (NANOULCOR) in patients with severe corneal ulcers.
Protocol code: FIB-NAN-2023-01
Sponsor: Fundacion Publica Para La Investigacion Biosanitaria De Andalucia Oriental Alejandro Otero (Patient organisation/association). Phase: Therapeutic exploratory (Phase II). Countries: Spain (temporarily halted).
Therapeutic area(s): Diseases [C] - Eye Diseases [C11]
Gender: Female, Male. Age: 18-64 years, 65+ years. Enrolment: 30.
Status: Temporarily halted. Start date (EU): 2025-03-12. Decision date: 2023-11-13. Results received: No. Last updated: 2025-09-16.

Condition(s): Corneal ulcer
Product: Alogenic sclerocorneal limbus stem adult limbal cells expanded combined with alogenic corneal diferenciated adult keratocytes expanded in biological matrix

Primary endpoint: The main efficacy variable will be the capacity of NANOULCOR to regenerate the trophic defect, compared to the control group. For this purpose, the difference between the two treatment groups will be assessed in the percentage of patients in whom the epithelial defect disappears. The status of the trophic defect will be assessed at all visits
Endpoint(s): Effectiveness Time to healing, Changes in visual acuity, Incidence of corneal complications according to the SOTOZONE scale, Changes in the patient's quality of life. Security Occurrence of AE and SAE. Status of the implanted corneal construct: maintenance of its integrity, detachment or resorption. Feasibility The percentage of patients in whom treatment with NANOULCOR has been feasible shall be recorded, including all points in the process

Source: https://euclinicaltrials.eu/ctis-public/view/2023-506856-25-00